EU clinical trial 2023-506400-99-00: Phase II randomized study evaluating a Pragmatic approach to Adoptive Cell Therapy (ACT) using an IL2 analog (ANV419/ANV600) vs High dose IL2 after Tumor Infiltrating Lymphocytes (TIL) Therapy in patients with melanoma, NSCLC and cervical cancer. The PragmaTIL
Protocol code: VHIO23002
Sponsor: Vall D Hebron Institute Of Oncology (Laboratory/Research/Testing facility). Phase: Therapeutic exploratory (Phase II). Countries: Denmark (ongoing, recruiting), Spain (ongoing, recruiting), Netherlands (authorised, recruitment pending).
Therapeutic area(s): Diseases [C] - Neoplasms [C04]
Gender: Female, Male. Age: 18-64 years, 65+ years. Enrolment: 24.
Start date (EU): 2025-01-15. Decision date: 2024-07-22. Results received: No. Last updated: 2026-07-23.
Decision dates by country: DK: 2024-07-22, ES: 2024-08-30, NL: 2024-07-24

Condition(s): Advanced selected solid tumors: melanoma, non-small cell lung cancer (NSCLC) and cervical cancer.
Product: Fludarabine - PCH 25 mg/ml, concentraat voor oplossing voor intraveneuze infusie of injectie, ANV419, Tumor Intiltrating Lymphocytes (TIL) – VHIO, PROLEUKIN, 18x106 UI polvo para solución inyectable o para perfusión, Fludarabina Teva 25 mg/ml concentrado para solución para perfusión o inyección EFG, PROLEUKIN® S 18 x 106 IE Pulver zur Herstellung einer Injektionslösung oder Infusionslösung, Melanoma Tumor Intiltrating Lymphocytes (TIL) – NKI, ENDOXAN I.V., poeder voor oplossing voor injectie (lyofilisaat) 750 mg, Melanoma Tumor Intiltrating Lymphocytes (TIL) – Herlev, Genoxal 1.000 mg polvo para solución inyectable y para perfusión, ANV600 2.5 mg/mL concentrate for solution for infusion, Fludarabinphosphat "Ebewe", koncentrat til injektions-/infusionsvæske, opløsning

Primary endpoint: Mean number of predefined grade ≥3 relevant AEs per treatment arm during the first 2 weeks from the first dose of interleukin administered. Predefined relevant AEs are rash, fatigue, myalgia, chills, fever, hypotension, arrhythmia, hypoxia, dyspnea, adult respiratory distress syndrome, urine output decreased, edema, weight gain, diarrhea, confusion, headache, anxiety, ALT increased, AST increased, bilirubin increased, and serum creatinine increased according to the NCI CTCAE v5.0, Change of PRO-CTCAE composite score (score 0-3 for each symptom) of selected events (diarrhea, fatigue, shortness of breath, rash, swelling, chills, heart palpitations, insomnia, anxious, sad, headache and muscle pain) from the baseline (within 3 days before TIL infusion) assessment to the first post-treatment evaluation.
Endpoint(s): Nature, frequency, and severity of treatment related adverse events according to the National Cancer Institute (NCI) Common Terminology Criteria for Adverse Events (CTCAE) per treatment arm, Overall Response Rate (ORR) per RECIST v1.1 as assessed by investigator., Duration of Response (DOR) per RECIST v1.1 as assessed by investigator., Tumor size calculated as the percentage change from baseline in tumor size (TS) to the time of the best response., Progression Free Survival (PFS), Overall survival (OS), Trajectories of quality of life and symptomatology using the EORTC QLQ-C30 and EQ-5D-5L questionnaires., Patient reported Anxiety and Depression as measured by the Hospital Anxiety and Depression Scale (HADS), Physiological parameters (Heartbeat, mobility, SpO2, and sleep cycle) captured by wearable device (Garmin VivoSmart 5 smartwatch), Qualitative evaluation of patient experience regarding themes around the care journey, expectations and uncertainty whilst undergoing TILs therapy through in-person or virtual qualitative interviews conducted before disease re-evaluation., Direct and indirect costs of TIL-ACT using HD-IL-2 and ANV600

Source: https://euclinicaltrials.eu/ctis-public/view/2023-506400-99-00